EU clinical trial 2022-501329-18-00: A study in healthy volunteers to improve methods for detection of GHB in drug rape victims
Sponsor: Aarhus University (Educational Institution). Phase: Phase III and phase IV (Integrated). Countries: Denmark (ended).
Therapeutic area(s): Diseases [C] - Nervous System Diseases [C10]
Gender: Female, Male. Age: 18-64 years, 65+ years. Enrolment: 30.
Status: Ended. Start date (EU): 2022-11-08. End date (EU): 2025-08-29. Decision date: 2022-09-12. Results received: Yes. Last updated: 2024-11-29.

Condition(s): Intoxication
Product: Natriumoxybat "Reig Jofre", oral opløsning, SODIUM CHLORIDE, PARACETAMOL

Primary endpoint: The primary end point of the trial is the time until the longest detectable biomarker in blood is no longer up- or downregulated in the active treatment group compared to the placebo group.
Endpoint(s): Time until the longest detectable biomarker in urine, oral fluid, or hair is no longer up- or downregulated in the active treatment group compared to the placebo group., Fold change in biomarkers identified in a previous study as listed in table 1 in a previous study of Wang, T. et al. (Retrospective Metabolomics Analysis of Gamma-Hydroxybutyrate in Humans: New Potential Markers and Changes in Metabolism Related to GHB Consumption), Fold change in metabolites in blood, urine, and oral fluid in all samples collected over time as analysed by metabolomics., Concentration of GHB and identified biomarkers in dental calculus at one, two, and four weeks., Concentration of GHB in absorbed sweat 1 day after intake of study medication., Verbal Paired Associates (VPA) score 1.5 hours after intake for GHB., Effect of drug on physical appearance 1.5 hours after intake (yes/no)., Concentration of GHB and possible biomarkers detected by routine screening.

Source: https://euclinicaltrials.eu/ctis-public/view/2022-501329-18-00